EU clinical trial 2024-512844-40-00: Vaginal progesterone as luteal support for improvement of live birth in frozen/thawed in-vitro fertilization natural cycles; a multicenter, open, randomized trial
Protocol code: ProFET
Sponsor: Vaestra Goetalandsregionen (Hospital/Clinic/Other health care facility). Phase: Therapeutic use (Phase IV). Countries: Iceland (ongoing, recruitment ended), Sweden (ongoing, recruitment ended).
Therapeutic area(s): Diseases [C] - Female Urogenital Diseases and Pregnancy Complications [C13]
Gender: Female. Age: 18-64 years. Enrolment: 1800.
Status: Ongoing, recruitment ended. Start date (EU): 2021-04-20. Decision date: 2024-06-26. Results received: No. Last updated: 2024-07-15.
Decision dates by country: IS: 2024-07-15, SE: 2024-06-26

Condition(s): Infertility
Product: Cyclogest 400 mg vagitorium, Lutinus 100 mg vaginaltabletter

Primary endpoint: Live birth
Endpoint(s): Biochemical pregnancy, clinical pregnancy, ongoing pregnancy, term pregnancy, miscarriage, ectopic pregnancy, termination of pregnancy, intrauterine fetal death, perinatal death., Perinatal outcomes: birth weight, gestational age, preterm birth (PTB), very PTB, low birth weight (LBW), very LBW, stillbirth, perinatal death (stillbirth + early neonatal death = neonatal death <7 days), birth defects detected at birth., Obstetric outcomes: hypertensive disorders of pregnancy (gestational hypertension and pre-eclampsia) (HDP), placenta previa, placenta abruption, postpartum hemorrhage (PPH)., Cost-effectiveness, Progesterone levels in blood samples from day LH+3

Source: https://euclinicaltrials.eu/ctis-public/view/2024-512844-40-00